EU clinical trial 2023-506803-25-01: AntaMIn - Pain reduction for limb injuries in pediatric emergency departments: A Randomised Clinical Trial comparing intranasal Fentanyl or intranasal Ketamine to oral morphine
Protocol code: APHP211044
Sponsor: Assistance Publique Hopitaux De Paris (Hospital/Clinic/Other health care facility). Phase: Phase II and Phase III (Integrated). Countries: France (ongoing, recruiting).
Therapeutic area(s): Analytical, Diagnostic and Therapeutic Techniques and Equipment [E] - Anesthesia and Analgesia [E03]
Gender: Female, Male. Age: 0-17 years. Enrolment: 300.
Status: Ongoing, recruiting. Start date (EU): 2025-02-26. Decision date: 2024-05-28. Results received: No. Last updated: 2025-11-26.

Condition(s): urgency, limb injuries
Product: MORPHINE SULFATE, KETAMINE, FENTANYL CITRATE, SODIUM CHLORIDE, SODIUM CHLORIDE

Primary endpoint: Success: children <7 years with a pain score assessed by Evendol < 5 or children ≥ 7 years with pain score assessed by VAS ≤ 30, 30 minutes after drugs administration, without rescue analgesia -Failure: Evendol ≥ 5 or VAS > 30, 30 minutes after drugs administration or need for rescue analgesia during the first 30 minutes after drugs administration
Endpoint(s): Success pain evaluation (success as defined in primary outcome) during the first 2 hours after drugs administration, at 15 (M15), 60 (M60), 90 (M90) and 120 minutes (M120), Reduction in pain scores from baseline at M15, M30, M60, M90 and M120, Level of sedation as measured by the University of Michigan Sedation Scale Score (UMSS) at 5, 10, 15, 30, 60, 90 and 120 minutes after drugs administration., - Adverse events potentially associated with IN ketamine, IN fentanyl and/or oral morphine: drowsiness, dizziness, pruritus, nausea, vomiting, dysphoria, nasal burning and irritation, unpleasant taste, vision changes, throat irritation, headache, vital sign changes (heart rate, respiratory rate, oxygen saturation, blood pressure)., General satisfaction of parents and patient ≥ 7 years old on a scale of 0–100 with corresponding faces (0 = no satisfaction at all, 100 = very satisfied) at ED discharge

Source: https://euclinicaltrials.eu/ctis-public/view/2023-506803-25-01